EU clinical trial 2025-522773-12-00: Prospective, randomised, double-blind, placebo-controlled multicenter clinical trial to evaluate efficacy and safety of immunotherapy in patients with rhinitis/rhinoconjunctivitis with or without mild to moderate asthma, allergic to Dermatophagoides pteronyssinus and/or Dermatophagoides farinae and Blomia tropicalis
Protocol code: MM17-SIT-077
Sponsor: Inmunotek S.L. (Pharmaceutical company). Phase: Therapeutic confirmatory (Phase III). Countries: Spain (authorised, recruitment pending).
Therapeutic area(s): Diseases [C] - Immune System Diseases [C20]
Gender: Female, Male. Age: 0-17 years, 18-64 years, 65+ years. Enrolment: 120.
Status: Authorised, recruitment pending. Decision date: 2026-05-18. Results received: No. Last updated: 2026-05-18.

Condition(s): Aetiological treatment of moderate-to-severe allergic rhinitis/rhinoconjunctivitis with or without mild-to-moderate controlled allergic asthma
Product: Same solution and presentation that active treatment but without active ingredients, D.pteronyssinus/D.farinae/B.tropicalis polymerized extracts 10,000 TU/mL suspension for injection

Primary endpoint: Rhinoconjunctivitis Combined Symptom and Medication Score (RCSMS) assessed over 4 weeks after one year of treatment, recorded using the Participant´s Diary
Endpoint(s): Rhinitis/Rhinoconjunctivitis Symptom Score (RSS), Rhinitis/Rhinoconjunctivitis Medication Score (RMS), Asthma-Combined Symptom and Medication Score (ACSMS), Asthma Symptom Score (ASS), Asthma Medication Score (AMS), Asthma and Rhinitis/Rhinoconjunctivitis Symptom Score (ARSS), Asthma and Rhinitis/Rhinoconjunctivitis Medication Score (ARMS), Asthma and Rhinitis/Rhinoconjunctivitis Combined Symptom and Medication Score (ARCSMS), Asthma exacerbations: time to first asthma exacerbation; number, duration, and severity., mmunological parameters*: Total IgE, Specific IgE and IgG4, and Specific IgE/Total IgE ratio., Allergen profiling (ALEX technique), Asthma Quality of Life Questionnaire (AQLQ), Rhinoconjunctivitis Quality of Life Questionnaire (RQLQ), Asthma Control Questionnaire (GINA 2025), Visual Analogue Scale (VAS), Consumption of Health Resources, Safety parameters: Overall rate and severity of adverse events (AEs) per administration and per subject, Evaluation of reactions at the site of administration, systemic reactions and of any medications administered for the treatment of the adverse reaction (AR). * Immunological parameters and allergen profiling (ALEX technique) will be carried out at Inmunotek or by an external laboratory contracted by the sponsor.

Source: https://euclinicaltrials.eu/ctis-public/view/2025-522773-12-00